EU clinical trial 2025-522225-35-00: Randomised, crossover bioequivalence clinical trial of edoxaban 60 mg tablets versus edoxaban 60 mg film-coated tablets, after a single oral dose administration to healthy volunteers under fasting conditions.
Protocol code: UECHUP-EDO/25-2
Sponsor: Laboratorios Alter S.A. (Pharmaceutical company). Phase: Human Pharmacology (Phase I)- Bioequivalence Study. Countries: Spain (ended).
Therapeutic area(s): Diseases [C] - Cardiovascular Diseases [C14]
Gender: Female, Male. Age: 18-64 years. Enrolment: 30.
Status: Ended. Start date (EU): 2025-06-23. End date (EU): 2025-07-21. Decision date: 2025-06-10. Results received: No. Last updated: 2025-06-18.
Decision dates by country: ES: 2025-06-18

Condition(s): Healthy volunteers

Source: https://euclinicaltrials.eu/ctis-public/view/2025-522225-35-00